EU clinical trial 2023-504075-25-00: Propranolol for early secondary prevention of post-traumatic stress disorder in female victims of sexual violence: a single-center, randomized, placebo-controlled pilot study - PPRESVISE
Protocol code: DR230070
Sponsor: Centre Hospitalier Regional Universitaire De Tours (Hospital/Clinic/Other health care facility). Phase: Therapeutic exploratory (Phase II). Countries: France (authorised, recruitment pending).
Therapeutic area(s): Psychiatry and Psychology [F] - Psychological Phenomena [F02]; Psychiatry and Psychology [F] - Behavior and Behavior Mechanisms [F01]
Gender: Female. Age: 18-64 years, 65+ years. Enrolment: 34.
Status: Authorised, recruitment pending. Decision date: 2025-02-17. Results received: No. Last updated: 2025-02-17.

Condition(s): Prevention of post-traumatic stress disorder
Product: Propranolol 40 mg film-coated tablets, microcrystalline cellulose

Primary endpoint: Taux de participantes présentant des symptômes du TSPT. La présence de ces symptômes sera évaluée par un soignant du Centre Régional de Psychotraumatologie à 5 semaines à l’aide de l’échelle CAPS-5 (Clinician Administered PTSD Scale pour le DSM-5).
Endpoint(s): Evaluer à 5 semaines : la symptomatologie de TSPT par auto-questionnaires (IES-R, Impact of Event Scale – Revised ; PCL-5, Posttraumatic Stress Disorder Checklist for DSM-5 ; PHQ-9, Patient Health Questionnaire)., Evaluer à 5 semaines : le retentissement sur le fonctionnement individuel par auto-questionnaires (FAST, Functional Assessment Staging Tool ; GAF, Global Assessment of Functioning ; EVA subjective de l’état de santé, Echelle Visuelle Analogique)., Evaluer à 3 mois: la symptomatologie de TSPT par auto-questionnaires (IES-R, PCL-5, PHQ-9), Evaluer à 3 mois : le retentissement sur le fonctionnement individuel par auto-questionnaires (FAST, GAF, EVA subjective de l’état de santé)., Evaluer à 3 mois : les coûts associés à la consommation de soins et aux arrêts de travail depuis J0., Evaluate at 3 months : Suicide risk using the C-SSRS scale, Evaluate at 6 months: PTSD symptomatology by self-questionnaires (IES-R, PCL-5, PHQ-9);, Evaluate at 6 months : Impact on individual functioning, using self-questionnaires (FAST, GAF, subjective VAS of health status), Collection of adverse events occurring during the study.

Source: https://euclinicaltrials.eu/ctis-public/view/2023-504075-25-00